EU clinical trial 2024-513104-34-00: A 14-week, multicentre, double-blind, randomised, placebo-controlled phase II study with an 8-week treatment period to assess the efficacy and tolerability of a fixed dose of BH-200 (250 mg BID) in outpatients with Major Depressive Disorder (MDD)
Protocol code: BH-200-03
Sponsor: HMNC Holding GmbH (Pharmaceutical company). Phase: Therapeutic exploratory (Phase II). Countries: Spain (ended), Estonia (ended), Slovakia (ended), Germany (ended), Poland (ended), Lithuania (ended), Bulgaria (ended).
Therapeutic area(s): Psychiatry and Psychology [F] - Mental Disorders [F03]
Gender: Female, Male. Age: 18-64 years, 65+ years. Enrolment: 274.
Status: Ended. Start date (EU): 2024-11-25. End date (EU): 2025-04-08. Decision date: 2024-09-24. Results received: Yes. Last updated: 2024-11-07.
Decision dates by country: BG: 2024-10-04, DE: 2024-10-02, LT: 2024-10-23, ES: 2024-09-24, PL: 2024-11-07, SK: 2024-09-24, EE: 2024-09-27

Condition(s): Major Depressive Disorder
Product: Placebo Nelivaptan Capsule, Nelivaptan, Nelivaptan

Primary endpoint: Change in the 17-item Hamilton Depression Rating Scale (HAMD-17) total score from baseline to visit 7.
Endpoint(s): Change in the Montgomery-Åsberg Depression Rating Scale (MADRS) total score from baseline to each planned post-baseline visit, where the MADRS is assessed (visit 5, visit 7 and visit 8 [follow-up visit])., Response rate (at least 50% reduction in the total score of HAMD-17 compared with baseline day 0) at each post-baseline visit., Remission rate (total score of HAMD-17 equal to or less than 7) at each post-baseline visit., Change in the HAMD-17 total score from baseline to each planned post-baseline visit., Change in the Clinical Global Impression-Severity of Illness rating scale (CGI-S) from baseline to each planned post-baseline visit., Change in the Hospital Anxiety and Depression Scale (HADS) total score, depressive sub-score, and anxiety sub-score from baseline to each planned post -baseline visit, Change in the 36-item Short Form Health Survey (SF-36, one-week recall version) from baseline to each planned post-baseline visit, where the SF-36 is assessed (visit 5, visit 7 and visit 8 [follow-up visit])., Change in the Sheehan Disability Scale (SDS) from baseline to each planned postbaseline visit, where the SDS is assessed (visit 5, visit 7 and visit 8 [follow-up visit])., Pharmacokinetic (PK) assessments., Change in suicidality, assessed by Columbia-Suicide Severity Rating Scale (C-SSRS) from baseline to each planned post-baseline visit., Number of reported adverse events (AEs), serious AEs (SAEs), number of reported clinical safety abnormalities (safety laboratory, electrocardiogram [ECG]).

Source: https://euclinicaltrials.eu/ctis-public/view/2024-513104-34-00